EU clinical trial 2025-522004-24-00: A Prospective, Open-Label, Randomized, Interventional Study to Evaluate the Efficacy and Tolerability of Sucrosomial® Iron vs Ferric Maltol in Iron Deficient Women
Protocol code: SID-WOMEN
Sponsor: Pharmanutra S.p.A. (Pharmaceutical company). Phase: Phase III and phase IV (Integrated). Countries: Spain (ongoing, recruiting).
Therapeutic area(s): Diseases [C] - Hemic and Lymphatic Diseases [C15]
Gender: Female. Age: 18-64 years, 65+ years. Enrolment: 146.
Status: Ongoing, recruiting. Start date (EU): 2025-12-11. Decision date: 2025-10-06. Results received: No. Last updated: 2026-05-15.

Condition(s): iron deficient
Product: Feraccru 30 mg hard capsules

Primary endpoint: Proportion of patients who achieved hemoglobin normalization at the end of the 12-week treatment period (Hb ≥ 12 g/dl).
Endpoint(s): Proportion of patients who achieved hemoglobin normalization at each timepoint, Proportion of patients who experience adverse events (AEs) or serious adverse events (SAEs)., Number of patients who withdraw from the study due to adverse events., Number of patients who discontinue treatment due to side effects., Proportion of patients who achieve normalization of laboratory values (sideremia, ferritin and TSAT)., Proportion of patients who show improvement in clinical symptoms according to the FACIT Fatigue Scale version 4.0., Differences in Hemoglobin level variation from baseline between Sucrosomial® Iron and Ferric Maltol treatments., Differences in Hemoglobin level variation at each timepoint between Sucrosomial® Iron and Ferric Maltol treatments., Differences in Hemoglobin level variation from baseline between Sucrosomial® Iron and Ferric Maltol treatments in the subgroup of women with chronic inflammation (based on baseline CRP values). CRP values categorized as follows: Normal (CRP < 0.3 mg/dl); Normal or minor elevation (0.3 ≤ CRP < 1.0 mg/dl); Moderate elevation (1.0 ≤ CRP ≤ 10.0 mg/dl); Marked elevation (CRP > 10.0 mg/dl)., Proportion of patients reporting refusal to take the product or discontinue due to its taste.

Source: https://euclinicaltrials.eu/ctis-public/view/2025-522004-24-00